EU clinical trial 2024-515316-44-00: A Phase 1b Study of JNJ-79635322 with Daratumumab With or Without Lenalidomide or JNJ-79635322 with Pomalidomide for Multiple Myeloma
Protocol code: 79635322MMY1002
Sponsor: Janssen Cilag International (Pharmaceutical company). Phase: Human Pharmacology (Phase I)- Other. Countries: Netherlands (ongoing, recruiting), Spain (ongoing, recruiting).
Therapeutic area(s): Diseases [C] - Neoplasms [C04]
Gender: Female, Male. Age: 18-64 years, 65+ years. Enrolment: 32.
Status: Ongoing, recruiting. Start date (EU): 2025-02-24. Decision date: 2024-12-16. Results received: No. Last updated: 2026-03-27.
Decision dates by country: NL: 2024-12-16, ES: 2024-12-17

Condition(s): Multiple Myeloma

Source: https://euclinicaltrials.eu/ctis-public/view/2024-515316-44-00